EU clinical trial 2024-518086-99-00: Young adults with early-onset obesity treated with semaglutide -The RESETTLE study - a randomized double blind placebo-controlled clinical trial
Protocol code: 2019-002274-31
Sponsor: Kobenhavns Universitet (Educational Institution). Phase: Therapeutic use (Phase IV). Countries: Denmark (ended).
Therapeutic area(s): Phenomena and Processes [G] - Metabolism [G03]
Gender: Female, Male. Age: 18-64 years. Enrolment: 255.
Status: Ended. Start date (EU): 2025-10-02. End date (EU): 2026-04-01. Decision date: 2024-10-02. Results received: No. Last updated: 2026-04-16.

Condition(s): Obesity
Product: SEMAGLUTIDE

Primary endpoint: Primary endpoints (change from V1 to V2) Change in BMI (weight in kg/(height in m)2) from before to after GLP-1 RA compared to placebo.
Endpoint(s): Secondary endpoints (change from V1 to V2) 1) Body composition 2) Body weight change 3) Participants with a reduction in body weight of at least 5%, 10%, 15%, and 20%

Source: https://euclinicaltrials.eu/ctis-public/view/2024-518086-99-00